EU clinical trial 2024-511728-15-00: An Open-Label, Multicenter, Phase 1/2 Study of RP1 as a Single Agent and in Combination with PD1 Blockade in Patients with Solid Tumors
Protocol code: RPL-001-16
Sponsor: Replimune Group Inc. (Pharmaceutical company). Phase: Phase I and Phase II (Integrated)- First administration to humans. Countries: Germany (ended), France (ended), Spain (ended).
Therapeutic area(s): Diseases [C] - Neoplasms [C04]
Gender: Female, Male. Age: 18-64 years, 65+ years. Enrolment: 81.
Status: Ended. Start date (EU): 2021-08-26. End date (EU): 2026-05-15. End date: 2026-05-16. Decision date: 2024-09-27. Results received: No. Last updated: 2026-04-10.
Decision dates by country: ES: 2024-09-27, FR: 2024-10-01, DE: 2024-10-01

Condition(s): Solid tumors
Product: Vusolimogene oderparepvec, OPDIVO 10 mg/mL concentrate for solution for infusion., Vusolimogene oderparepvec, Vusolimogene oderparepvec, Vusolimogene oderparepvec, Vusolimogene oderparepvec

Primary endpoint: Phase 1: The primary endpoint for determination of MTD is the incidence of AEs and clinical laboratory abnormalities defined as DLT, Phase 1: The primary endpoints for determination the safety and tolerability of RP1 alone and in combination with nivolumab will be determined by the incidence of all TEAEs, ≥ Grade 3 TEAEs, SAEs, events requiring withdrawal from IP treatment, Phase 2: Primary Efficacy Endpoints • ORR for RP1 in combination with nivolumab using RECIST v1.1 as modified for use in this study as determined by Investigator review, Phase 2: Primary Efficacy Endpoint: ORR for RP1 in combination with nivolumab using RECIST v1.1 as modified for use in this study assessed by independent review for the anti-PD1 failed cutaneous melanoma coh, Phase 2: Primary Safety Endpoints • Incidence of TEAEs, using CTCAE v5.0, ≥ Grade 3 TEAEs and SAEs in all patients, Phase 2: Primary Safety Endpoint: Incidence of TEAEs, using CTCAE v5.0, requiring withdrawal from the study treatment in all patients
Endpoint(s): Phase 1: Incidence of changes in individual tumor sizes, inflammation, necrosis and erythema in injected and noninjected tumor, Phase 1: Incidence of clearance of RP1 from blood and urine before and after each injection, Phase 1:Rate of RP1 detection on exterior of the dressing, injected lesions, saliva/oral mucosa and lesions that are herpetic in appearance, Phase 1: Changes in HSV-1 antibody levels during treatment compared to baseline, Phase 1: Overall ORR as assessed by modified RECIST v1.1, Phase 1: Dose Expansion Phase only: Incidence of positive PD-L1 expression, CD8+ T cell infiltration and positive interferon-gamma gene signature by Nanostring analysis, Phase 1:Duration of clinical benefit defined as duration of CR, PR, or SD according to modified RECIST v1.1, Phase 2: Secondary Efficacy Endpoints: ORR, DOR, CR rate, DCR, PFS, and OS according to Investigator review, Phase 2: Secondary Efficacy Endoints: ORR, DOR, CR rate, DCR, PFS, and OS will also be assessed by independent central review for the anti-PD1 failed cutaneous melanoma cohort, Phase 2: Secondary Efficacy Endoints: Time to next therapy, Phase 2:To assess the incidence of clearance of RP1 from blood and urine overall, by baseline HSV1 serostatus, and by route of injection (superficial vs deep), Phase 2: To assess rate of detection of RP1 from the injection site, exterior of the injection site dressing, oral mucosa/saliva, and any lesions that appear herpetic during the study, Phase 2: To assess evidence of immune response through biomarker analysis of tumor biopsy and peripheral blood specimens in select patients, Phase 2: To assess the changes in levels of anti–HSV-1 antibodies during RP1 treatment compared to baseline, Phase 2: To explore the response rates in lesions that were never injected, Phase 2: To assess health-related quality of life for patients in the anti-PD1 failed cutaneous melanoma cohort using the EORTC QLQ-C30

Source: https://euclinicaltrials.eu/ctis-public/view/2024-511728-15-00